EU clinical trial 2024-516551-41-00: A Phase 2, open-label, multicenter study to evaluate efficacy and safety of zanidatamab for the treatment of participants with previously treated HER2-expressing solid tumors (DiscovHER PAN-206)
Protocol code: JZP598-206
Sponsor: Jazz Pharmaceuticals Ireland Limited (Pharmaceutical company). Phase: Therapeutic exploratory (Phase II). Countries: Spain (ongoing, recruiting).
Therapeutic area(s): Diseases [C] - Neoplasms [C04]
Gender: Female, Male. Age: 18-64 years, 65+ years. Enrolment: 125.
Status: Ongoing, recruiting. Start date (EU): 2026-03-06. Decision date: 2025-11-13. Results received: No. Last updated: 2026-07-01.

Condition(s): Patients with HER2-expressing solid tumors
Product: JZP598

Primary endpoint: cORR per ICR as assessed by RECIST version 1.1
Endpoint(s): 1. DOR per ICR as assessed by RECIST version 1.1 • Investigator-assessed cORR and DOR per RECIST version 1.1 • ICR- and investigator-assessed (per RECIST version 1.1): − TTR − DCR − PFS • OS, 2. Frequency of TEAEs and SAEs as graded by • NCI CTCAE version 5.0 or higher • Frequency of dose reductions • Frequency of discontinuations of treatment due to TEAEs, 3. Serum concentrations of zanidatamab, 4. Frequency, duration, and time of onset of anti-zanidatamab antibodies and neutralizing antibodies, if applicable, 5. The frequency and severity of symptomatic AEs prior to first dose of study intervention and during the on-treatment period, based on the PRO-CTCAE and EORTC Item Library • The percent of all treated participants reporting each level of side-effect bother while on treatment, based on the FACIT-GP5 •The level of side-effect bother reported over time per participant, summarized as the percent of time on treatment with high side-effect bother, based on the FACIT-GP5

Source: https://euclinicaltrials.eu/ctis-public/view/2024-516551-41-00